EU clinical trial 2025-522972-97-00: Evaluation of the safety, tolerability, and effectiveness of CTH120 in adult males with Fragile X syndrome
Protocol code: CTH-CTH120-FXS-01
Sponsor: Connecta Therapeutics S.L. (Pharmaceutical company). Phase: Therapeutic exploratory (Phase II). Countries: Spain (ongoing, recruiting).
Therapeutic area(s): Diseases [C] - Congenital, Hereditary, and Neonatal Diseases and Abnormalities [C16]
Gender: Male. Age: 18-64 years. Enrolment: 30.
Status: Ongoing, recruiting. Start date (EU): 2026-05-21. Decision date: 2025-12-01. Results received: No. Last updated: 2026-06-19.

Condition(s): Fragile X Syndrome
Product: A matching placebo will be provided as hard capsules. The placebo contains the same compendial excipients than the investigational medicinal product and are identical in appearance to the investigational medicinal product hard capsules.

Primary endpoint: Treatment-emergent adverse events (TEAEs) from Day 1 to the End-of-study (EOS), Treatment-emergent potentially clinically significant abnormalities (PSCAs) in vital signs, 12-lead ECG and safety laboratory parameters from Day 1 to EOS
Endpoint(s): Exploratory plasma pharmacokinetics of CTH120 (Cmax, Ctrough, Clast, tmax, tlag, tlast, AUC0-t, AUC0-∞, AUCextrap %, λz, t1/2, CL/F, Vz/F, RAC AUC0-t and RAC Cmax), Exploratory plasma pharmacokinetics of metabolite M4 (Cmax, Ctrough, Clast, tmax, tlag, tlast, AUC0-t, AUC0-∞, AUCextrap %, λz, t1/2, MR Cmax, MR AUC0-t, and MR AUC0-∞, RAC AUC0-t and RAC Cmax), Exploratory PK values assessment considering the different CYP2D6 metaboliser phenotypes, Global functioning using the Visual Analogue Scale (VAS), Global severity and improvement using the Clinical Global Impression Improvement Scale (CGI-S and CGI- I), Behaviour troubles using the Aberrant Behaviour Checklist-Community in FXS (ABC-CFXS), Cognitive functioning using the NIH-TCB-ID, Anxiety using the Anxiety, Depression, and Mood Scale (ADAMS), Adaptive functioning using the Vineland Adaptive Behaviour Scale (VABS-3), Cognitive functioning using the PedsQL 3.0 Cognitive Functioning Scale (PARENT Reports for Young Adults (ages 18-25) and Adults (ages over 26), Quality of life using the PedsQL 4.0 Generic Core Scales (PARENT Reports for Young Adults (ages 18-25) and Adults (ages over 26), Quality of life using the PedsQL 2.0 Family Impact Module (parent impact for all ages), Quality of sleep using the Pittsburgh sleep quality index (PSQI), Neural functioning using Electroencephalography (EEG) (auditory oddball, resting-state and auditory steady-state response), Social attention using eye-tracking, Biorhythm characteristics using Actigraphy, Protein levels of FMRP in peripheral blood, BDNF concentrations in plasma, miRNA profile in plasma (Tertiary endpoint)

Source: https://euclinicaltrials.eu/ctis-public/view/2025-522972-97-00